EU clinical trial 2023-509695-42-00: Efficacy and safety of riociguat (MK-4836) in incipient pulmonary vascular disease as an indicator for early pulmonary arterial hypertension; Double-blind, randomized, multicenter, multinational, placebo-controlled phase IIa study
Protocol code: 2020-01RCT
Sponsor: Thoraxklinik Heidelberg gGmbH (Hospital/Clinic/Other health care facility). Phase: Therapeutic exploratory (Phase II). Countries: France (ended), Germany (ended), Austria (ended), Italy (ended).
Therapeutic area(s): Diseases [C] - Cardiovascular Diseases [C14]
Gender: Female, Male. Age: 18-64 years, 65+ years. Enrolment: 43.
Status: Ended. Start date (EU): 2022-07-25. End date (EU): 2025-07-31. End date: 2025-08-01. Decision date: 2024-11-07. Results received: Yes. Last updated: 2025-04-30.
Decision dates by country: AT: 2024-12-08, FR: 2024-11-07, IT: 2024-11-13, DE: 2024-11-12

Condition(s): Pulmonary vascular disease
Product: Riociguat Bayer, Riociguat Bayer, Riociguat Bayer, Riociguat Bayer, Riociguat Bayer, Cellulose microcrystaline; lactose monohydrate; magnesium stearate

Primary endpoint: Pulmonary vascular resistance, change from baseline to 24 weeks
Endpoint(s): change of cardiac index at rest (baseline to 24 weeks), change of total pulmonary resistance (baseline to 24 weeks), change of diffusion capacity of the lung (baseline to 24 weeks), change of 6-minute walking distance (baseline to 24 weeks), change of WHO functional class (baseline to 24 weeks), change in QoL (SF-36, physical summation score; baseline to 24 weeks)

Source: https://euclinicaltrials.eu/ctis-public/view/2023-509695-42-00